EU clinical trial 2023-507405-34-00: A Phase III Randomized, Double-Blind, Placebo-Controlled, Multi-Regional, International Study of Durvalumab in Combination with Gemcitabine plus Cisplatin versus Placebo in Combination with Gemcitabine plus Cisplatin for Patients with First-Line Advanced Biliary Tract Cancers (TOPAZ-1)
Protocol code: D933AC00001
Sponsor: Astrazeneca AB (Pharmaceutical company). Phase: Therapeutic confirmatory (Phase III). Countries: Poland (ongoing, recruitment ended), Bulgaria (ended), Italy (ended), France (ended).
Therapeutic area(s): Diseases [C] - Neoplasms [C04]
Gender: Female, Male. Age: 18-64 years, 65+ years. Enrolment: 125.
Start date (EU): 2019-08-07. Decision date: 2024-06-05. Results received: No. Last updated: 2025-09-23.
Decision dates by country: PL: 2024-06-07, IT: 2024-06-10, FR: 2024-06-05, BG: 2024-06-10

Condition(s): First-line patients with advanced biliary tract cancers (BTC)
Product: CISPLATIN, INFLIXIMAB, IMFINZI 50 mg/mL concentrate for solution for infusion., GEMCITABINE, MYCOPHENOLATE MOFETIL

Primary endpoint: Overall survival
Endpoint(s): Progression-free survival (PFS), ORR (Objective response rate) , and Duration of response (DoR) according to RECIST 1.1using Investigator assessments, ORR and DoR according to RECIST 1.1 using BICR assessments, EORTC QLQ-C30: Global health status/QoL and impacts (eg, physical function); multi-term symptoms (eg, fatigue); and single items (eg, appetite loss, insomnia). EORTC QLQ-BIL21: Single-item symptoms (eg, abdominal pain [item 42], pruritus [item 36], jaundice [item 35]), Association of PD-L1 expression level with PFS, ORR, DoR, and DCR (Disease control rate) according to RECIST 1.1 using Investigator assessments and OS (Overall survival), Serum concentration of durvalumab (peak and trough concentrations), Presence of ADAs for durvalumab (confirmatory results: positive or negative)

Source: https://euclinicaltrials.eu/ctis-public/view/2023-507405-34-00